EU clinical trial 2023-504460-41-00: Relative Bioavailability and Effect of Food Study With AGMB-129 in Healthy Participants
Protocol code: AGMB-129-C103
Sponsor: Agomab Spain S.L. (Pharmaceutical company). Phase: Human Pharmacology (Phase I)- Other. Countries: Belgium (ended).
Therapeutic area(s): Diseases [C] - Digestive System Diseases [C06]
Gender: Female, Male. Age: 18-64 years. Enrolment: 24.
Status: Ended. Start date (EU): 2024-01-30. End date (EU): 2024-05-13. Decision date: 2023-07-25. Results received: No. Last updated: 2024-04-04.

Condition(s): Fibrostenotic Crohn’s disease

Source: https://euclinicaltrials.eu/ctis-public/view/2023-504460-41-00